EU clinical trial 2023-504239-41-00: Phase 3 Multicenter, Randomized, Double-Blind, Study to Assess the Efficacy and Safety of Treatment with Bepirovirsen in Nucleos(t)ide Analogue-treated Participants with Chronic Hepatitis B Virus (B-Well 1)
Protocol code: 202009
Sponsor: Glaxosmithkline Research & Development Limited (Pharmaceutical company). Phase: Therapeutic confirmatory (Phase III). Countries: Spain (ended), Romania (ended), France (ended), Hungary (ended), Italy (ended), Germany (ended), Poland (ended), Bulgaria (ended), Greece (ended).
Therapeutic area(s): Diseases [C] - Virus Diseases [C02]
Gender: Female, Male. Age: 18-64 years, 65+ years. Enrolment: 226.
Status: Ended. Start date (EU): 2023-01-09. End date (EU): 2026-03-17. End date: 2026-04-15. Decision date: 2024-01-10. Results received: No. Last updated: 2026-01-21.
Decision dates by country: BG: 2024-01-29, DE: 2024-01-12, ES: 2024-01-11, FR: 2024-01-10, GR: 2024-02-26, HU: 2024-01-11, PL: 2024-02-23, RO: 2024-01-16, IT: 2024-01-12

Condition(s): Hepatitis B, Chronic
Product: Placebo for Bepirovirsen Solution for Injection 150 mg/mL

Primary endpoint: Functional cure for 24 weeks after discontinuation of all chronic HBV treatment (bepirovirsen/placebo and NA) in the absence of rescue medication

Source: https://euclinicaltrials.eu/ctis-public/view/2023-504239-41-00